EU clinical trial 2022-502215-10-00: Open-label, long-term safety and efficacy study of Mim8 in participants with haemophilia A with or without inhibitors
Protocol code: NN7769-4532
Sponsor: Novo Nordisk A/S (Pharmaceutical company). Phase: Therapeutic confirmatory (Phase III). Countries: Spain (ongoing, recruiting), Austria (ongoing, recruitment ended), Italy (ongoing, recruiting), Bulgaria (ongoing, recruitment ended), Poland (ongoing, recruitment ended), Belgium (ongoing, recruitment ended), Denmark (ongoing, recruitment ended), France (ongoing, recruiting), Germany (ongoing, recruiting), Ireland (ongoing, recruitment ended), Latvia (ongoing, recruitment ended), Lithuania (ongoing, recruitment ended), Portugal (ongoing, recruitment ended), Romania (ongoing, recruitment ended), Netherlands (ongoing, recruitment ended), Slovakia (ongoing, recruitment ended).
Therapeutic area(s): Diseases [C] - Congenital, Hereditary, and Neonatal Diseases and Abnormalities [C16]
Gender: Female, Male. Age: 0-17 years, 18-64 years, 65+ years. Enrolment: 106.
Start date (EU): 2023-05-04. Decision date: 2023-04-17. Results received: No. Last updated: 2026-07-02.
Decision dates by country: DE: 2023-10-30, LV: 2023-09-22, AT: 2023-04-18, NL: 2023-10-19, SK: 2023-10-19, PT: 2023-10-24, PL: 2023-04-18, IE: 2023-10-27, ES: 2023-04-17, DK: 2023-09-28, FR: 2023-10-25, IT: 2023-04-18, BE: 2023-10-19, RO: 2023-10-02, LT: 2023-10-27, BG: 2023-04-19

Condition(s): Haemophilia A (with or without inhibitors)
Product: denecimig, denecimig, denecimig, denecimig, denecimig

Primary endpoint: Number of treatment‑emergent adverse events. From visit 1 (week 0) until end of study (up to 283 weeks).
Endpoint(s): Number of injection site reactions. From visit 1 (week 0) until end of treatment (up to 262 weeks)., Occurrence of anti Mim8 antibodies. From visit 1 (week 0) until end of treatment (up to 262 weeks)., Number of treated bleeding episodes. From visit 1 (week 0) until end of treatment (up to 262 weeks)., Number of treated spontaneous bleeding episodes. From visit 1 (week 0) until end of treatment (up to 262 weeks)., Number of treated traumatic bleeding episodes. From visit 1 (week 0) until end of treatment (up to 262 weeks)., Number of treated joint bleeding episodes. From visit 1 (week 0) until end of treatment (up to 262 weeks)., Number of treated target joint bleeding episodes (arm 2). From visit 1 (week 0) until end of treatment (up to 262 weeks)., Mim8 plasma concentration. From visit 1 (week 0) until end of treatment (up to 262 weeks)., Device handling experience using Haemophilia Device Assessment Tool (HDAT) (applicable for participants in Arm 2 only).

Source: https://euclinicaltrials.eu/ctis-public/view/2022-502215-10-00